EU clinical trial 2023-504912-13-00: 177Lu-PSMA as a systemic adjuvant treatment in patients with high and very high risk prostate cancer after radical treatment with locoregional teleradiotherapy and hormone therapy.
Protocol code: PSMA-ADJUVO
Sponsor: Narodowy Instytut Onkologii Im. Marii Sklodowskiej-Curie-Panstwowy Instytut Badawczy (Hospital/Clinic/Other health care facility). Phase: Therapeutic exploratory (Phase II). Countries: Poland (ongoing, recruiting).
Therapeutic area(s): Diseases [C] - Neoplasms [C04]
Gender: Male. Age: 18-64 years, 65+ years. Enrolment: 200.
Status: Ongoing, recruiting. Start date (EU): 2025-01-09. Decision date: 2023-09-11. Results received: No. Last updated: 2026-04-07.

Condition(s): Prostate Cancer
Product: Pluvicto 1 000 MBq/mL solution for injection/infusion

Primary endpoint: The assessment of biochemical failure ratio.
Endpoint(s): Biochemical Progression Free Survival - time of survival from the end of 177Lu-PSMA treatment to biochemical progression or death., Radiological Progression Free Survival - time of survival from the end of 177Lu-PSMA treatment to the radiological progression defined accoring to the PCWG3 criteria or death., Time from the end of 177Lu-PSMA treatment to inclusion of other therapeutic intervention., Frequency and count of Patients with adverse events., The comparison of quality of life ratios (EORTC QLQ-PR25) between study groups.

Source: https://euclinicaltrials.eu/ctis-public/view/2023-504912-13-00